EU clinical trial 2024-520391-10-01: Efficacy and safety of early intramuscular botulinum toxin injections in the prevention of shoulder deformity in infants with obstetric brachial plexus palsy: a randomized double-blind multicenter controlled trial.
Protocol code: POPBTOX
Sponsor: Centre Hospitalier Regional Et Universitaire De Brest (Hospital/Clinic/Other health care facility). Phase: Therapeutic confirmatory (Phase III). Countries: France (authorised, recruiting).
Therapeutic area(s): Diseases [C] - Musculoskeletal Diseases [C05]
Gender: Female, Male. Age: 0-17 years. Enrolment: 62.
Status: Authorised, recruiting. Start date (EU): 2025-05-30. Decision date: 2025-01-30. Results received: No. Last updated: 2025-04-28.

Condition(s): Obstetrical Brachial Plexus Palsy
Product: SODIUM CHLORIDE, BOTOX 100 Unità Allergan Polvere per soluzione iniettabile

Primary endpoint: Evolution of the percentage of posterior migration of the humeral head measured in MRI on an axial section, between 11 months (before botulinum toxin injection at 12 months) and 18 months (6 months after injection) of age.
Endpoint(s): 2D glenoid evolution measured in MRI on an axial slice (1st secondary objective), Evolution of the glenoid version and three-dimensional humeral head migration on MRI (1st secondary objective), Changes in passive joint amplitudes (2nd secondary objective), Evolution of the AMS (Active Movement Scale) (2nd secondary objective), Progression of mini-AHA (mini-Assistive Hand Assessment) score (2nd secondary objective), Assessment of the number of non-serious and serious adverse events (3rd secondary objective), Assessment of trophicity (muscle volume) and fatty infiltration of injected muscles (supraspinatus, infraspinatus and lesser round, subscapularis, greater round, pectoralis major, deltoid, greater dorsalis) (4th secondary objective)., Surgical management of the children included in each group will be recorded post-study during medical follow-up (routine clinical practice) up to the 10th year of life after the blind has been lifted (5th secondary objective).

Source: https://euclinicaltrials.eu/ctis-public/view/2024-520391-10-01